EU clinical trial 2023-508952-21-00: B7461039 LORLATINIB (PF-06463922) CONTINUATION PROTOCOL: AN OPEN-LABEL, SINGLE-ARM CONTINUATION STUDY FOR PARTICIPANTS WITH ALKPOSITIVE OR ROS1-POSITIVE NON-SMALL CELL LUNG CANCER (NSCLC) CONTINUING FROM PFIZER SPONSORED LORLATINIB CLINICAL STUDIES
Protocol code: B7461039
Sponsor: Pfizer Inc. (Pharmaceutical company). Phase: Therapeutic use (Phase IV). Countries: Spain (ongoing, recruitment ended), France (ongoing, recruitment ended).
Therapeutic area(s): Diseases [C] - Neoplasms [C04]
Gender: Female, Male. Age: 18-64 years. Enrolment: 17.
Status: Ongoing, recruitment ended. Start date (EU): 2022-08-02. Decision date: 2024-01-17. Results received: No. Last updated: 2026-04-07.
Decision dates by country: ES: 2024-01-17, FR: 2024-02-16

Condition(s): Lung cancer
Product: LORLATINIB

Primary endpoint: AEs leading to permanent discontinuation of lorlatinib, All SAEs

Source: https://euclinicaltrials.eu/ctis-public/view/2023-508952-21-00